EU clinical trial 2025-524599-52-03: Paracervical block with ropivacaine for pain relief in second trimester medical abortion - a double blind placebo controlled randomized trial
Protocol code: PCBPCA 1
Sponsor: Karolinska Institutet (Educational Institution). Phase: Therapeutic confirmatory (Phase III). Countries: Sweden (authorised, recruitment pending).
Therapeutic area(s): Diseases [C] - Female Urogenital Diseases and Pregnancy Complications [C13]
Gender: Female. Age: 18-64 years. Enrolment: 132.
Status: Authorised, recruitment pending. Decision date: 2026-07-17. Results received: No. Last updated: 2026-07-17.

Condition(s): abortion
Product: ROPIVACAINE, ELECTROLYTES

Primary endpoint: Primary outcome is maximum pain score on a VAS (measured in millimeters) during the procedure

Source: https://euclinicaltrials.eu/ctis-public/view/2025-524599-52-03